EU clinical trial 2025-520812-33-00: CARDIOPROTECTIVE-NEPHROPROTECTIVE EFFECTS OF SEVOFLURANE IN COMPARISON WITH PROPOFOL IN DOUBLE VALVE SURGERY. USE OF SEVOFLURANE AS A PILLAR OF PROTECTION IN EXTRACORPOREAL CIRCULATION AND POSTOPERATIVE SEDATION
Sponsor: Fundacion Publica Andaluza Para La Investigacion De Malaga En Biomedicina Y Salud (Laboratory/Research/Testing facility). Phase: Phase II and Phase III (Integrated). Countries: Spain (authorised, recruitment pending).
Therapeutic area(s): Diseases [C] - Cardiovascular Diseases [C14]
Gender: Female, Male. Age: 18-64 years, 65+ years. Enrolment: 70.
Status: Authorised, recruitment pending. Decision date: 2025-01-27. Results received: No. Last updated: 2025-01-27.

Condition(s): To evaluate the effects of sevoflurane administration intra- (including the period of extracorporeal circulation ischemia) and postoperatively in patients undergoing double valve surgery with respect to propofol in terms of reducing myocardial damage and injury. For this, the levels of NT-ProBNP and troponin I will be measured; and its impact on myocardial preservation, through the measurement of the cardiac index intraoperatively and immediately postoperatively, as well as the use of inotropes for low cardiac output syndrome.
Product: Propofol Eignapharma 10 mg/ml Emulsão injetável/para perfusão

Primary endpoint: Evaluation variables: Sex, age, Cardiac index, creatinine, N-GAL, Stroke Volume index, heart rate, beats / min, mean arterial pressure, right ventricular end-diastolic pressure, Troponin I, NT-ProBNP, pre/postconditioning enzymes, renal dysfunction, inotropic support, days of ICU stay and circRNA values

Source: https://euclinicaltrials.eu/ctis-public/view/2025-520812-33-00